EU clinical trial 2025-525088-34-00: RASolute 303: A Phase 3 Global, Multicenter, Open-label, Randomized, 3-Arm Study of Daraxonrasib Monotherapy or Daraxonrasib Plus Gemcitabine and Nab-paclitaxel versus Gemcitabine and Nab-paclitaxel as a First-Line Treatment for Patients with Metastatic Pancreatic Adenocarcinoma
Protocol code: RMC-6236-303
Sponsor: Revolution Medicines Inc. (Pharmaceutical company). Phase: Therapeutic confirmatory (Phase III). Countries: Poland (authorised, recruitment pending), Belgium (authorised, recruitment pending), Norway (authorised, recruitment pending), Sweden (authorised, recruitment pending), Austria (authorised, recruitment pending), Germany (authorised, recruitment pending), Denmark (authorised, recruitment pending), Netherlands (authorised, recruitment pending), France (not authorised), Italy (authorised, recruitment pending), Spain (authorised, recruitment pending).
Therapeutic area(s): Diseases [C] - Digestive System Diseases [C06]
Gender: Female, Male. Age: 18-64 years, 65+ years. Enrolment: 337.
Decision date: 2026-07-14. Results received: No. Last updated: 2026-07-27.
Decision dates by country: AT: 2026-07-27, BE: 2026-07-17, DK: 2026-07-20, FR: 2026-07-27, DE: 2026-07-16, IT: 2026-07-14, ES: 2026-07-17, SE: 2026-07-15, NL: 2026-07-20, NO: 2026-07-21, PL: 2026-07-23

Condition(s): Metastatic Pancreatic Adenocarcinoma
Product: DARAXONRASIB (RMC-6236), Abraxane 5 mg/ml powder for dispersion for infusion., Gemcitabin HEXAL 40 mg/ml Konzentrat zur Herstellung einer Infusionslösung, Gemcitabin Hikma 38 mg/ml Konzentrat zur Herstellung einer Infusionslösung, DARAXONRASIB (RMC-6236)

Primary endpoint: Progression free survival (PFS) PFS is defined as the time from randomization until disease progression or death from any cause, whichever occurs first. Progression is per response evaluation criteria in solid tumors (RECIST) v1.1 and as assessed by Investigator. [Time Frame: Up to approximately 2 years], Overall survival (OS) OS is defined as the time from randomization until death from any cause. [Time Frame: Up to approximately 2 years]
Endpoint(s): Objective response rate (ORR) Objective response is defined as partial response (PR) or complete response (CR) per RECIST v1.1, as assessed by the Investigator. [Time Frame: Up to approximately 2 years], Duration of response (DOR) DOR is defined as time from first evidence of objective response (PR or CR) to disease progression or death due to any cause, whichever occurs first, as assessed by the Investigator [Time Frame: Up to approximately 2 years], Concentration of daraxonrasib in Arm A and B Pre-dose trough and post-dose blood concentrations of daraxonrasib at selected visits. [Time Frame: Up to Cycle 5 Day 1 (each cycle is 28 days)], Health-related outcome assessed by European Organization for Research and Treatment of Cancer Quality of Life Questionnaire Pancreatic Cancer Module (EORTC QLQ-PAN26) Change from baseline in EORTC QLQ-PAN26 pain scale [Time Frame: Up to approximately 2 years], Quality of life as assessed with European Organization for Research and Treatment of Cancer Quality of Life Questionnaire Core 30 (EORTC QLQ-C30) Change from baseline in EORTC QLQ-C30 global health status [Time Frame: Up to approximately 2 years], Incidence of adverse events (AEs) Percentage of patients with AEs as assessed by Common Terminology Criteria for Adverse Events (CTCAE) v5 [Time Frame: Up to approximately 2 years], Changes in vital signs Changes from baseline in vital signs [Time Frame: Up to approximately 2 years], Changes in clinical laboratory test values Changes from baseline in clinical laboratory test values [Time Frame: Up to approximately 2 years]

Source: https://euclinicaltrials.eu/ctis-public/view/2025-525088-34-00